EU clinical trial 2023-509347-27-00: A Randomized, Multicenter, Open-Label, Non-Inferiority, Phase 3 Study of ACP-196 Versus Ibrutinib in Previously Treated Subjects with High Risk Chronic Lymphocytic Leukemia
Protocol code: ACE-CL-006
Sponsor: Acerta Pharma B.V. (Pharmaceutical company). Phase: Therapeutic confirmatory (Phase III). Countries: Poland (ongoing, recruitment ended), Spain (ongoing, recruitment ended).
Therapeutic area(s): Diseases [C] - Neoplasms [C04]
Gender: Female, Male. Age: 18-64 years, 65+ years. Enrolment: 17.
Status: Ongoing, recruitment ended. Start date (EU): 2015-09-30. Decision date: 2024-05-14. Results received: No. Last updated: 2026-07-29.
Decision dates by country: ES: 2024-05-14, PL: 2024-05-16

Condition(s): High Risk Chronic Lymphocytic Leukaemia
Product: Calquence 100 mg film-coated tablets, IMBRUVICA 140 mg hard capsules, IMBRUVICA 140 mg hard capsules, Calquence 100 mg hard capsules

Primary endpoint: To assess whether ACP-196 is non-inferior to ibrutinib with respect to progression-free survival (PFS) based on independent review committee (IRC) assessment in subjects with relapsed or refractory chronic lymphocytic leukemia (CLL) with high-risk prognostic markers.
Endpoint(s): To compare between ACP-196 and ibrutinib in terms of: •Incidence of Grade ≥ 3 infections •Incidence of Richter's transformation •Incidence of atrial fibrillation •OS

Source: https://euclinicaltrials.eu/ctis-public/view/2023-509347-27-00